EU clinical trial 2023-507340-36-00: A study to investigate the safety, tolerability, and pharmacokinetics of Ent001 in patients with moderately to severely active ulcerative colitis
Protocol code: Ent001-CL-102
Sponsor: Enthera S.r.l. (Pharmaceutical company). Phase: Human Pharmacology (Phase I)- Other. Countries: Romania (ended), Netherlands (ended), Bulgaria (ended), Hungary (ended).
Therapeutic area(s): Diseases [C] - Digestive System Diseases [C06]
Gender: Female, Male. Age: 18-64 years, 65+ years. Enrolment: 40.
Status: Ended. Start date (EU): 2024-04-22. End date (EU): 2025-05-14. End date: 2025-08-18. Decision date: 2024-03-18. Results received: No. Last updated: 2025-07-07.
Decision dates by country: HU: 2024-05-29, NL: 2024-03-18, BG: 2024-03-25, RO: 2024-03-21

Condition(s): Inflammatory bowel disease (moderate to severe active ulcerative colitis)

Source: https://euclinicaltrials.eu/ctis-public/view/2023-507340-36-00